EU clinical trial 2022-501930-49-00: Oral antibiotics to prevent infection and wound dehiscence after obstetric perineal tear - a double-blinded placebo controlled randomized trail
Sponsor: Herlev Hospital (Hospital/Clinic/Other health care facility). Phase: Therapeutic use (Phase IV). Countries: Denmark (ended).
Therapeutic area(s): Diseases [C] - Female Urogenital Diseases and Pregnancy Complications [C13]
Gender: Female. Age: 18-64 years. Enrolment: 442.
Status: Ended. Start date (EU): 2023-03-21. End date (EU): 2024-12-02. Decision date: 2023-02-02. Results received: Yes. Last updated: 2023-02-02.

Condition(s): Obstetric perineal ruptur
Product: Bioclavid 500 mg/125 mg filmdragerade tabletter, Placebo, 17 mm delekærv

Primary endpoint: Number of women with perineal infection or wound dehiscence
Endpoint(s): Number of women with complications after one week and one year. Complications being investigated: incontinence, pelvic prolaps, pain, sexsual dysfunktions

Source: https://euclinicaltrials.eu/ctis-public/view/2022-501930-49-00